EU clinical trial 2023-510423-30-00: Concentration of Unbound Cloxacillin in Adults Treated with Continuous Infusion via Elastomeric Pump
Sponsor: Region Vaestmanland (Hospital/Clinic/Other health care facility). Phase: Therapeutic use (Phase IV). Countries: Sweden (ongoing, recruiting).
Therapeutic area(s): Diseases [C] - Bacterial Infections and Mycoses [C01]
Gender: Female, Male. Age: 18-64 years, 65+ years. Enrolment: 25.
Status: Ongoing, recruiting. Start date (EU): 2025-12-12. Decision date: 2025-07-25. Results received: No. Last updated: 2025-07-25.

Condition(s): Staphylococcus aureus infection
Product: Cloxacillin Stragen 2 g pulver till injektions-/infusionsvätska, lösning

Primary endpoint: Concentration of total and free (unbound) cloxacillin at four time points; at the start of continuous infusion, 4h (±1h) after the start of continuous infusion, 24h (±1h) after the start of continuous infusion, and 48h (±1h) after the start of continuous infusion.

Source: https://euclinicaltrials.eu/ctis-public/view/2023-510423-30-00